EU clinical trial 2024-514879-17-00: Randomised Phase III Trial of First Line Intraperitoneal Paclitaxel and Systemic Therapy versus Systemic Therapy Alone in Gastric Cancer Patients with Peritoneal Metastases
Protocol code: IPa-Gastric 1.0
Sponsor: Karolinska University Hospital (Hospital/Clinic/Other health care facility). Phase: Therapeutic confirmatory (Phase III). Countries: Italy (authorised, recruitment pending), Sweden (ongoing, recruiting), Netherlands (authorised, recruitment pending), Norway (authorised, recruitment pending).
Therapeutic area(s): Diseases [C] - Neoplasms [C04]
Gender: Female, Male. Age: 18-64 years, 65+ years. Enrolment: 96.
Start date (EU): 2025-11-05. Decision date: 2025-08-04. Results received: No. Last updated: 2026-06-10.
Decision dates by country: IT: 2025-08-04, NL: 2025-08-04, NO: 2025-08-06, SE: 2025-08-04

Condition(s): Gastric cancer
Product: TRASTUZUMAB, PEMBROLIZUMAB, ZOLBETUXIMAB, FLUOROURACIL, NIVOLUMAB, CAPECITABINE, IRINOTECAN, OXALIPLATIN, PACLITAXEL, DOCETAXEL

Primary endpoint: Overall survival (OS), defined as time from randomisation to death from any cause.
Endpoint(s): Toxicity/adverse Events (AE) according to CTCAE v5.0 in patients treated with IP paclitaxel., HRQoL assessed using EORTC QLQ-C30 and EORTC OG-25 during treatment and follow-up., Progression-free survival (PFS), defined as time from randomisation to first documentation of radiological tumor progression, progression of peritoneal carcinomatosis index (PCI), radiological progression of ascites, need for drainage of ascites or death, whichever occurs first, Radiological response of treatment on ascites present at baseline., Quantifying the amount of ascites drained from the randomisation date to date of censoring, death or end of study., Proportion of patients in each study arm, 1. Fulfilling the criteria for, 2. Undergoing, curative intent conversion surgery., Time (in days) from randomisation to the first clinical or radiological evidence of small or large bowel obstruction between the two treatment groups

Source: https://euclinicaltrials.eu/ctis-public/view/2024-514879-17-00